EU clinical trial 2023-508236-60-00: A Single-Arm, Open-Label, Phase 1 Study to Determine the Safety, Tolerability and Preliminary Efficacy of Obecabtagene Autoleucel in Patients with Severe, Refractory Systemic Lupus Erythematosus
Protocol code: AUTO1-SL1
Sponsor: Autolus Limited (Pharmaceutical company). Phase: Human Pharmacology (Phase I)- Other. Countries: Spain (ongoing, recruiting).
Therapeutic area(s): Diseases [C] - Immune System Diseases [C20]
Gender: Female, Male. Age: 18-64 years, 65+ years. Enrolment: 6.
Status: Ongoing, recruiting. Start date (EU): 2024-06-13. Decision date: 2024-03-18. Results received: No. Last updated: 2026-07-27.
Decision dates by country: ES: 2024-06-06

Condition(s): Severe, Refractory Systemic Lupus Erythematosus

Source: https://euclinicaltrials.eu/ctis-public/view/2023-508236-60-00